EU clinical trial 2024-511271-15-00: A Phase Ib/II, Open-Label, Multicenter, Randomized Umbrella Study Evaluating the Efficacy and Safety of Multiple Immunotherapy-Based Treatment Combinations in Patients With Metastatic Pancreatic Ductal Adenocarcinoma (Morpheus–Pancreatic Cancer)
Protocol code: WO39608
Sponsor: F. Hoffmann-La Roche AG (Pharmaceutical company). Phase: Phase I and Phase II (Integrated)- Other. Countries: Spain (ended).
Therapeutic area(s): Diseases [C] - Neoplasms [C04]
Gender: Female, Male. Age: 18-64 years, 65+ years. Enrolment: 29.
Status: Ended. Start date (EU): 2017-11-23. End date (EU): 2025-02-07. End date: 2025-02-27. Decision date: 2024-04-04. Results received: Yes. Last updated: 2024-04-04.

Condition(s): Pancreatic ductal adenocarcinoma (PDAC)
Product: Abraxane 5 mg/ml powder for dispersion for infusion., Gemcitabin-GRY 1000 mg Pulver zur Herstellung einer Infusionslösung, RoActemra 20 mg/mL concentrate for solution for infusion, Gemcitabin AqVida 38 mg/ml Pulver zur Herstellung einer Infusionslösung, Gemcitabin Kabi 38 mg/ml Pulver zur Herstellung einer Infusionslösung, Avastin 25 mg/ml concentrate for solution for infusion., ATEZOLIZUMAB, Tiragolumab

Primary endpoint: 1. Objective response
Endpoint(s): 1. Progression free survival, 2. Overall survival, 3. Overall survival at specific timepoints, 4. Duration of response, 5. Disease control, 6. Incidence, nature, and severity of adverse events and laboratory abnormalities, 7. Change from baseline in vital signs and ECG parameters, 8. Change from baseline in targeted clinical laboratory test results

Source: https://euclinicaltrials.eu/ctis-public/view/2024-511271-15-00